EU clinical trial 2024-514246-37-00: A Phase IIb, multicentre, randomised, doubleblind, placebocontrolled, three-arm parallel-group study to evaluate the efficacy, safety, and tolerability at Week 24 of 2 doses of CHF10067 (zampilimab), with an optional 24-week doubleblind, placebocontrolled extension phase in participants with idiopathic pulmonary fibrosis
Protocol code: CLI-10067AA1-02
Sponsor: Chiesi Farmaceutici S.p.A. (Pharmaceutical company). Phase: Therapeutic exploratory (Phase II). Countries: Belgium (authorised, recruitment pending), Germany (authorised, recruitment pending), Italy (authorised, recruitment pending), Czechia (authorised, recruitment pending), Bulgaria (authorised, recruitment pending), Netherlands (authorised, recruitment pending), France (not authorised), Portugal (authorised, recruitment pending), Poland (authorised, recruitment pending), Spain (authorised, recruitment pending), Romania (authorised, recruitment pending).
Therapeutic area(s): Diseases [C] - Respiratory Tract Diseases [C08]
Gender: Female, Male. Age: 18-64 years, 65+ years. Enrolment: 103.
Decision date: 2026-04-27. Results received: No. Last updated: 2026-05-04.
Decision dates by country: BE: 2026-04-27, BG: 2026-04-30, FR: 2026-04-27, DE: 2026-04-30, IT: 2026-04-28, PT: 2026-04-28, RO: 2026-05-04, ES: 2026-04-30, NL: 2026-04-30, PL: 2026-04-30, CZ: 2026-04-28

Condition(s): Idiopathic pulmonary fibrosis (IPF)
Product: 0.9% sodium chloride aqueous solution for IV infusion

Primary endpoint: Week 24
Endpoint(s): 1- Efficacy thorughout the duration of the study at Weeks 0, 6, 12, 18, 24 and 30, 2 - Week 0 through to Week 21

Source: https://euclinicaltrials.eu/ctis-public/view/2024-514246-37-00